EU clinical trial 2024-510921-25-00: Antibiotic Impregnated Bone Graft to reduce infection in hip replacement - the ABOGRAFT trial
Sponsor: Region Oestergoetland (Hospital/Clinic/Other health care facility). Phase: Therapeutic exploratory (Phase II). Countries: Sweden (ongoing, recruiting).
Therapeutic area(s): Diseases [C] - Bacterial Infections and Mycoses [C01]; Diseases [C] - Musculoskeletal Diseases [C05]; Analytical,Diagnostic,Therapeutic Techniques and Equipment [E]-Surgical Procedures, Operative [E04]; Phenomena and Processes [G] - Musculoskeletal and Neural Physiological Phenomena [G11]
Gender: Female, Male. Age: 18-64 years, 65+ years. Enrolment: 1100.
Status: Ongoing, recruiting. Start date (EU): 2022-03-18. Decision date: 2024-03-19. Results received: No. Last updated: 2026-03-30.

Condition(s): Prosthetic Joint Infection
Product: VANCOMYCIN, TOBRAMYCIN, SALINE

Primary endpoint: Reoperation due to infection or diagnosed PJI with bacteria that are sensitive to either vancomycin or tobramycin, in the same hip joint, within two years after hip arthroplasty
Endpoint(s): Time and cause for reoperation for any reason within 2 and 5 years, Time and cause for implant revision due to any reason within 2 and 5 years, Type of microbe and antibiotic resistance pattern for cases complicated with postoperative infection, Differences between the two experimental groups regarding the frequencies of adverse events, Differences between the two experimental groups regarding the rates of revision due to aseptic loosening

Source: https://euclinicaltrials.eu/ctis-public/view/2024-510921-25-00